EU clinical trial 2025-522441-21-00: Open-Label, Multi Stage Study to Optimize the Intraputaminal Administration of AB-1005 Using a Prescriptive Infusion Algorithm (PIA)
Protocol code: ASK-PD5-CS202
Sponsor: Askbio Inc. (Pharmaceutical company). Phase: Therapeutic exploratory (Phase II). Countries: Poland (authorised, recruitment pending).
Therapeutic area(s): Diseases [C] - Nervous System Diseases [C10]
Gender: Female, Male. Age: 18-64 years, 65+ years. Enrolment: 15.
Status: Authorised, recruitment pending. Decision date: 2026-04-03. Results received: No. Last updated: 2026-05-28.

Condition(s): Parkinson's Disease
Product: AAV2-GDNF, ProHance, 279,3 mg/ml (0,5 mmol/ml), roztwór do wstrzykiwan

Primary endpoint: Incidence and severity of AEs including: serious adverse events (SAEs), treatment-emergent adverse events (TEAEs), TEAEs related to device and/or surgical procedure, TEAEs related to study drug
Endpoint(s): Absolute values and changes from baseline in: MoCA score, BDI-II score, C-SSRS , vital sign parameters, physical examinations, clinical laboratory measures, and neuroimaging findings, Immunological responses to AAV2 and/or GDNF, End-of-infusion volumetric coverage of the putamen as assessed by MRI, Duration of surgical procedure, Accuracy of cannula tip placement at targeted first and last infusion points in the putamen

Source: https://euclinicaltrials.eu/ctis-public/view/2025-522441-21-00